EU clinical trial 2025-523593-16-00: First adjuvant trial in locally resected aggressive pancreatic neuroendocrine tumors: a randomized phase III investigating the efficacy of systemic chemotherapy (ADJUPANET)
Protocol code: CSET 2025 / 4242
Sponsor: Institut Gustave Roussy (Hospital/Clinic/Other health care facility). Phase: Therapeutic confirmatory (Phase III). Countries: France (authorised, recruitment pending).
Therapeutic area(s): Diseases [C] - Neoplasms [C04]
Gender: Female, Male. Age: 18-64 years, 65+ years. Enrolment: 504.
Status: Authorised, recruitment pending. Decision date: 2026-06-10. Results received: No. Last updated: 2026-06-10.

Condition(s): Pancreatic NeuroEndocrine Tumors (PanNET) ; Aggressive stage I-III well differentiated R0 resected
Product: Capecitabine Accord 500 mg film-coated tablets, Temodal 100 mg hard capsules, Temodal 250 mg hard capsules, Capecitabine Accord 150 mg film-coated tablets, Temodal 180 mg hard capsules, Temodal 5 mg hard capsules, Temodal 140 mg hard capsules, Temodal 20 mg hard capsules, Capecitabine Accord 300 mg film-coated tablets

Primary endpoint: Arm ADJUPANET : - Disease-free survival (DFS), defined as the time between randomization and the diagnosis of first recurrence or death. -Subjects who are alive with no objective documentation of one of the events by the data cutoff date for DFS analysis will be censored at the date of their last evaluable follow-up data. As the treatment policy strategy is adopted, intercurrent events (treatment discontinuation and use of subsequent anti-cancer therapy) will all be ignored., Arm ADJUPANET-OBS:-Disease-free survival (DFS) defined as the time between date of randomization refusal and the diagnosis of first recurrence or death. - Subjects who are alive with no objective documentation of one of the events by the data cutoff date for DFS analysis will be censored at the date of their last evaluable follow-up data. As the treatment policy strategy is adopted, intercurrent events (treatment discontinuation and use of subsequent anti-cancer therapy) will all be ignored.
Endpoint(s): Arm ADJUPANET : Specific survival: defined as the time from randomization to death due to disease progression, toxicity of the treatment or uncontrollable secretory syndrome. Subjects who have not died at the time of data cut-off for the final analysis will be censored at the date the patient was last known to be alive., ARM ADJUPANET: Overall survival: defined as the time from randomization to death from any cause. Subjects who have not died at the time of data cut-off for the final analysis will be censored at the date the patient was last known to be alive., ARM ADJUPANET : Toxicity: using the National Cancer Institute Common Terminology Criteria for Adverse Events version 6.0 (NCI CTCAE v6.0) at baseline, every month during the first year and then every year until the end of the study, ARM ADJUPANET :Time and pattern of recurrence: time from randomization to the detection of recurrence (first local / distant recurrence / death) and pattern of recurrence analyzed as competing risks (Fine and Gray) with the three following competing events: local recurrence (pancreatic margin, regional lymph nodes or operative bed), distant (including peritoneal outside the operative bed) (or synchronous local and distant) recurrence and death without recurrence., ARM ADJUPANET: Quality of life: evolution of the scores from the EORTC QLQ-C30 (11), the NET specific EORTC QLQ-GINET21 (12) and EQ-5D-5L questionnaires (global scores, main domains and symptoms, specific questions) collected at baseline, every three months during one year, and then every year until the end of the study., Observational cohort of patients (ADJUPANET-OBS): outcome of ADJUPANET patients with the outcome of ADJUPANET-OBS patients eligible for but not randomized into ADJUPANET to see how the outcome of the randomized patients compares with real-life, clinical practice data. And, if feasible, to augment the analysis of ADJUPANET with patients from the ADJUPANET-OBS cohort to compare the outcome of patients treated with chemotherapy + active surveillance, Observational cohort of patients (ADJUPANET-OBS):The primary, secondary and exploratory objectives will be the same than for the ADJUPANET trial. DFS and OS will be estimated since the registration date, and no QoL data will be collected

Source: https://euclinicaltrials.eu/ctis-public/view/2025-523593-16-00